EU clinical trial 2023-510537-28-00: DREAMM 7: A Multicenter, Open-Label, Randomized Phase III Study to Evaluate the Efficacy and Safety of the Combination of Belantamab Mafodotin, Bortezomib, and Dexamethasone (B-Vd) Compared with the Combination of Daratumumab, Bortezomib and Dexamethasone (D-Vd) in Participants with Relapsed/Refractory Multiple Myeloma
Protocol code: 207503
Sponsor: Glaxosmithkline Research & Development Limited (Pharmaceutical company). Phase: Therapeutic confirmatory (Phase III). Countries: Spain (ongoing, recruitment ended), Czechia (ongoing, recruiting), Germany (authorised, recruitment pending), Netherlands (ongoing, recruitment ended), Belgium (ongoing, recruitment ended), Poland (ongoing, recruitment ended), France (ongoing, recruiting), Italy (ongoing, recruitment ended), Greece (ongoing, recruitment ended).
Therapeutic area(s): Diseases [C] - Hemic and Lymphatic Diseases [C15]
Gender: Female, Male. Age: 18-64 years, 65+ years. Enrolment: 203.
Start date (EU): 2020-05-15. Decision date: 2024-06-10. Results received: No. Last updated: 2026-07-09.
Decision dates by country: IT: 2024-06-18, PL: 2024-06-13, ES: 2024-06-10, CZ: 2024-06-11, GR: 2024-07-16, DE: 2024-06-14, BE: 2024-06-14, NL: 2024-06-14, FR: 2024-06-27

Condition(s): Multiple Myeloma
Product: Dexamethasone 2mg Tablets, Dexamethason 8 mg JENAPHARM®, Dexa 8 mg inject JENAPHARM Injektionslösung, Dexamethason 8 mg GALEN® Tabletten, VELCADE 3.5 mg powder for solution for injection, Dexamethasone Tablets BP 2.0mg, DARZALEX 20 mg/mL concentrate for solution for infusion, Dexa-ratiopharm® 8 mg Injektionslösung

Primary endpoint: Progression-Free Survival (PFS), defined as the time from the date of randomization until the earliest date of documented disease progression or death due to any cause
Endpoint(s): Overall Survival (OS), defined as the time from the date of randomization until the date of death due to any cause, Duration of Response (DoR), defined as the time from first documented evidence of PR or better until progressive disease (PD) or death due to any cause, Minimal Residual Disease (MRD) negativity rate, defined as the percentage of participants who are MRD negative by next-generation sequencing (NGS), Complete Response Rate (CRR), defined as the percentage of participants with a confirmed complete response (CR) or better, Overall Response Rate (ORR), defined as the percentage of participants with a confirmed partial response (PR) or better, Clinical Benefit Rate (CBR), defined as the percentage of participants with a confirmed minimal response (MR) or better per IMWG, Time to Response (TTR), defined as the time between the date of randomization and the first documented evidence of response (PR or better) among participants who achieve confirmed PR or better, Time to Progression (TTP), defined as the time from the date of randomization until the earliest date of documented PD or death due to PD, PFS2, defined as time from randomization to disease progression after initiation of new anti-myeloma therapy or death from any cause, whichever is earlier., If disease progression after new anti-myeloma therapy cannot be measured, a PFS event is defined as the date of discontinuation of new anti-myeloma therapy, or death from any cause, whichever is earlier, Incidence of adverse events (AEs) and changes in laboratory parameters, Ocular findings on ophthalmic exam, Plasma concentrations of belantamab mafodotin, and cys-mcMMAF, Incidence and titers of ADAs against belantamab mafodotin, Maximum post-baseline PRO-CTCAE score for each item attribute, Change from baseline in HRQOL as measured by EORTC QLQ-C30 and EORTC IL52 (disease symptoms domain from the EORTC QLQ-MY20)

Source: https://euclinicaltrials.eu/ctis-public/view/2023-510537-28-00